EU clinical trial 2024-517214-16-00: Randomized, double-blind, placebo-controlled trial evaluating efficacy and safety of dimethyl fumarate in brain atrophy reduction, synaptic functional connectivity, cognitive functions, quality of life, and activity of daily living improvement among patients with mild cognitive impairment and dementia due to Alzheimer’s disease
Protocol code: 010622
Sponsor: Medical University Of Lodz (Educational Institution). Phase: Therapeutic exploratory (Phase II). Countries: Poland (ongoing, recruiting).
Therapeutic area(s): Psychiatry and Psychology [F] - Mental Disorders [F03]
Gender: Female, Male. Age: 18-64 years, 65+ years. Enrolment: 100.
Status: Ongoing, recruiting. Start date (EU): 2024-10-28. Decision date: 2024-11-05. Results received: No. Last updated: 2026-03-07.

Condition(s): Alzheimer’s disease
Product: DIMETHYL FUMARATE

Primary endpoint: Change in cognitive performance as assessed by RBANS scores between the post-treatment visit (V9) and the randomisation visit (V1).
Endpoint(s): Assessment of the daily functioning of patients based on the ADCS-ADL scale, Assessment of the presence of neuropsychiatric symptoms / behavioral disorders in patients using the NPI, GDS scale),, Assessment of the quality of life of patients and their caregivers based on the EQ-5D scales, Zarit Burden Interview,, Assessment of the expression of peripheral markers of oxidative stress and pro-inflammatory markers., Improvement of cognitive functions using MMSE, CDR in patients diagnosed with MCI and AD receiving dimethyl fumarate after the end of therapy compared to the placebo group., Difference in frequency and severity of reported adverse events in the active group versus the placebo group.

Source: https://euclinicaltrials.eu/ctis-public/view/2024-517214-16-00